EU clinical trial 2023-505638-82-00: A Phase III, Multicenter, Single-Arm Study Evaluating the Efficacy, Safety, Pharmacokinetics, and Pharmacodynamics of Crovalimab in Pediatric Patients with Atypical Hemolytic Uremic Syndrome (aHUS)
Protocol code: BO42354
Sponsor: F. Hoffmann-La Roche AG (Pharmaceutical company). Phase: Therapeutic confirmatory (Phase III). Countries: Belgium (ongoing, recruitment ended), Spain (ended), Italy (ended), France (ongoing, recruitment ended), Hungary (ended), Poland (ongoing, recruitment ended).
Therapeutic area(s): Diseases [C] - Hemic and Lymphatic Diseases [C15]
Gender: Female, Male. Age: 0-17 years. Enrolment: 9.
Start date (EU): 2022-01-12. Decision date: 2024-02-23. Results received: No. Last updated: 2026-01-19.
Decision dates by country: ES: 2024-02-26, HU: 2024-02-23, FR: 2024-02-26, BE: 2024-03-11, PL: 2024-03-29, IT: 2024-02-27

Condition(s): Atypical Hemolytic Uremic Syndrome (aHUS)
Product: Crovalimab, Crovalimab

Primary endpoint: 1. Proportion of patients with complete TMA response (cTMAr) anytime from baseline to Week 25 (after 24 weeks on treatment)
Endpoint(s): 1. Change from baseline to Week 25 in dialysis requirement status, 2. Observed value and change from baseline to Week 25 (after 24 weeks on treatment); in estimated glomerular filtration rate (eGFR), 3. Proportion of patients with change from baseline to Week 25 (after 24 weeks on treatment) in chronic kidney disease (CKD) stage classified as improved, stable (no change), or worsened based on the National Kidney Foundation Chronic Kidney Disease Stage, 4. Observed value and change from baseline to Week 25 (after 24 weeks on treatment) in hematologic parameters, 5. Incidence and severity of adverse events, 6. Change in targeted vital signs and clinical laboratory test results, 7. Incidence and severity of injection site reactions, infusion related reactions, hypersensitivity, malignant hypertension, and infections, 8. Incidence of adverse events leading to study drug discontinuation, 9. Serum concentration of crovalimab, 10. Prevalence and incidence of anti-drug antibodies (ADAs) to crovalimab, 11. Proportion of patients with platelet count >= LLN, 12. Proportion of patients with normalization of LDH, 13. Proportion of patients with >=25% decrease in serum creatinine from baseline, 14. Time to complete TMA response (cTMAr), 15. Duration of cTMAr, among patients who achieved cTMAr, 16. Proportion of patients with cTMAr, 17. Proportion of patients with maintained TMA control (mTMAc) from baseline through Week 25, 18. Incidence and severity of clinical manifestations of drug-target-drug complexes (DTDCs) in patients who switched to crovalimab treatment from either eculizumab or ravulizumab treatment

Source: https://euclinicaltrials.eu/ctis-public/view/2023-505638-82-00